EU clinical trial 2024-515539-31-00: A Phase 2 Randomized, Placebo-Controlled, Double-Blind, Parallel-group Study to Evaluate the Efficacy and Safety of MK-1167 as Adjunctive Therapy in Participants with Mild to Moderate Alzheimer’s Disease Dementia
Protocol code: MK-1167-008
Sponsor: Merck Sharp & Dohme LLC (Pharmaceutical company). Phase: Therapeutic exploratory (Phase II). Countries: Netherlands (ended), Italy (ended), Spain (ended).
Therapeutic area(s): Diseases [C] - Nervous System Diseases [C10]
Gender: Female, Male. Age: 18-64 years, 65+ years. Enrolment: 79.
Status: Ended. Start date (EU): 2025-04-01. End date (EU): 2026-05-28. End date: 2026-07-01. Decision date: 2025-03-18. Results received: No. Last updated: 2026-05-07.
Decision dates by country: IT: 2025-03-19, NL: 2025-03-19, ES: 2025-03-18

Condition(s): Alzheimer’s disease dementia
Product: Placebo to MK-1167, MK-1167, MK-1167, MK-1167

Primary endpoint: Change From Baseline in the Alzheimer's Disease Assessment Scale-11-item Cognitive Subscale (ADAS-Cog11) Total Score at Week 24, Number of participants who experience one or more adverse events (AEs), Number of participants who discontinue study intervention due to an AE
Endpoint(s): Alzheimer's Disease Cooperative Study Clinical Global Impression of Change (ADCS-CGIC) Overall Score at Week 24, Change From Baseline in The Alzheimer's Disease Cooperative Study Activities of Daily Living (ADCS-ADL) Total Score at Week 24, Change From Baseline in the ADAS-Cog11 Total Score at Week 12, ADCS-CGIC Overall Score at Week 12, Change From Baseline in the ADCS-ADL Total Score at Week 12

Source: https://euclinicaltrials.eu/ctis-public/view/2024-515539-31-00